EU clinical trial 2025-524967-19-00: HMBeacon: A Phase 2, Randomized, Double-blind Study of the Safety, Tolerability, Efficacy, and Pharmacodynamics of Multiple Dose ALN-6400 in Female Patients with Von Willebrand Disease (VWD) and Heavy Menstrual Bleeding (HMB)
Protocol code: ALN-6400-002
Sponsor: Alnylam Pharmaceuticals Inc. (Pharmaceutical company). Phase: Therapeutic exploratory (Phase II). Countries: Netherlands (authorised, recruitment pending), Sweden (authorised, recruitment pending), Germany (authorised, recruitment pending).
Therapeutic area(s): Diseases [C] - Cardiovascular Diseases [C14]
Gender: Female. Age: 18-64 years. Enrolment: 5.
Status: Authorised, recruitment pending. Decision date: 2026-07-08. Results received: No. Last updated: 2026-07-15.
Decision dates by country: DE: 2026-07-08, SE: 2026-07-15, NL: 2026-07-15

Condition(s): Von Willebrand Disease (VWD) and Heavy Menstrual Bleeding (HMB)

Primary endpoint: Frequency of AEs. Safety will also be evaluated through vital signs, ECGs, and clinical laboratory assessments.
Endpoint(s): - Change from baseline in PLG o Plasma activity levels o Plasma protein levels - Change from baseline in menstrual blood loss via PBAC - PRO scores o PGI-C o Change from baseline in PGI-S

Source: https://euclinicaltrials.eu/ctis-public/view/2025-524967-19-00